EU clinical trial 2023-505632-35-00: Open-Label, Randomized, Multicenter, Multi-Dose, Active Controlled, Parallel-Group, Efficacy and Safety Study of BG00012 in Children from 10 to Less Than 18 Years of Age with Relapsing-Remitting Multiple Sclerosis with Optional Open-Label Extension (CONNECT)
Protocol code: 109MS306
Sponsor: Biogen Idec Research Limited (Pharmaceutical company). Phase: Therapeutic confirmatory (Phase III). Countries: France (ended).
Therapeutic area(s): Diseases [C] - Nervous System Diseases [C10]
Gender: Female, Male. Age: 0-17 years. Enrolment: 37.
Status: Ended. Start date (EU): 2014-07-24. End date (EU): 2025-07-08. End date: 2025-07-08. Decision date: 2024-10-17. Results received: Yes. Last updated: 2024-10-17.

Condition(s): Relapsing-Remitting Multiple Sclerosis
Product: TECFIDERA

Primary endpoint: The primary endpoint of Part 1 of the study is the proportion of participants free of new/newly enlarging T2 hyperintense lesions on brain MRI scans at Week 96., The primary endpoint of the Part 2 is the incidence of adverse events, serious adverse events and discontinuations of BG00012 due to an adverse event
Endpoint(s): Part 1: Number of new/newly enlarging T2 hyperintense lesions on brain MRI scans at Weeks 24 and 96, Proportion of participants free of new/newly enlarging T2 hyperintense lesions on brain MRI scans at Weeks 24 and 48, Proportion of participants free of new MRI activity (new MRI activity includes: Gd enhancing MRI lesion on brain MRI scans; new T2 MRI lesions on brain MRI scans and newly enlarging LRI lesions on brain MRI scans) at Weeks 24, 48, and 96, Time to first relapse up to week 96, Proportion of participants who do not experience relapse up to Week 96, Annualized relapse rate at Weeks 48 and 96, Number of participants that experience Adverse Events (AEs) and serious adverse events (SAEs) Including prospective and followup of flushing, nausea, abdominal pain and diarrhea up to Week 96, Fatigue as measured by the Pediatric Quality of Life Inventory (PedsQL) Multidimensional Fatigue Scale scores up to Week 96, Change from baseline to Week 96 in the Expanded Disability Status Scale (EDSS) score up to Week 96., Vital signs, electrocardiograms (ECGs) and changes in clinical laboratory data, including monitoring of liver function, renal function, hematologic, and coagulation parameters up to Week 96., Part 2: include annualized relapse rate; EDSS; cognition as measured by BVMT-R, SDMT, and school progression query; vital signs; ECGs; clinical laboratory data; changes from baseline in height, weight, and bone age; and Tanner stage.

Source: https://euclinicaltrials.eu/ctis-public/view/2023-505632-35-00